EU clinical trial 2024-512791-36-00: LP0162-1335: A single (assessor) blinded, randomized, parallel-group, monotherapy trial to evaluate the pharmacokinetics and safety of tralokinumab in children (age 6 to <12 years) with moderate to-severe atopic dermatitis. - TRAPEDS 1 (TRAlokinumab PEDiatric trial no. 1).
Protocol code: LP0162-1335
Sponsor: Leo Pharma A/S (Pharmaceutical company). Phase: Therapeutic exploratory (Phase II). Countries: France (ended), Spain (ended), Netherlands (ended), Czechia (ended).
Therapeutic area(s): Diseases [C] - Skin and Connective Tissue Diseases [C17]
Gender: Female, Male. Age: 0-17 years. Enrolment: 20.
Status: Ended. Start date (EU): 2022-08-24. End date (EU): 2026-04-29. End date: 2026-04-30. Decision date: 2024-09-03. Results received: No. Last updated: 2026-02-12.
Decision dates by country: ES: 2024-09-03, NL: 2024-09-03, FR: 2024-09-06, CZ: 2024-09-05

Condition(s): Treatment of moderate-to-severe Atopic dermatitis
Product: Adtralza 150 mg solution for injection in pre-filled syringe

Primary endpoint: 1. Ctrough at Week 16., 2. Cmax between Week 12-Week 14 for Q2W (Week 12-Week 16 for Q4W).The endpoint will also be summarized by dosing interval within the low dose level, 3. AUC between Week 12-Week 14 for Q2W (Week 12-Week 16 for Q4W).The endpoint will also be summarized by dosing interval within the low dose level, 4. Tmax between Week 12-Week14 for Q2W (Week 12-Week 16 for Q4W).The endpoint will also be summarized by dosing interval within the low dose level
Endpoint(s): 1. Number of treatment‑emergent adverse events in the initial treatment period (Week 0 to Week 16)., 2. Anti-drug antibodies (status) in the initial treatment period (Week 0 to Week 16)., 3. Number of treatment‑emergent adverse events in the open-label treatment period (Week 16 to Week 68)., 4. Anti-drug antibodies (status) in the open-label treatment period (Week 16 to Week 68)., 5. Number of treatment-emergent adverse events in the long term extension treatment period (Week 68 to end of treatment visit (The end-of-treatment visit is held 2 weeks after end of treatment (defined as the date of the last IMP dose for each subject))., 6. Anti-drug antibodies (status) in the long term extension treatment period (Week 68 to end-of-treatment visit (The end-of-treatment visit is held 2 weeks after end of treatment (defined as the date of the last IMP dose for each subject))., 7. Change in SCORAD from Week 0 to Week 68., 8. Change in POEM from Week 0 to Week 68., 9. Change in EASI from Week 0 to Week 68.

Source: https://euclinicaltrials.eu/ctis-public/view/2024-512791-36-00